EU clinical trial 2023-507871-23-00: C1071032 - MAGNETISMM-32 A PHASE 3, OPEN-LABEL STUDY OF ELRANATAMAB MONOTHERAPY VERSUS ELOTUZUMAB, POMALIDOMIDE, DEXAMETHASONE (EPd) OR POMALIDOMIDE, BORTEZOMIB, DEXAMETHASONE (PVd) OR CARFILZOMIB, DEXAMETHASONE (Kd) IN PARTICIPANTS WITH RELAPSED REFRACTORY MULTIPLE MYELOMA WHO RECEIVED PRIOR ANTI-CD38 DIRECTED THERAPY
Protocol code: C1071032
Sponsor: Pfizer Inc. (Pharmaceutical company). Phase: Therapeutic confirmatory (Phase III). Countries: Norway (ongoing, recruiting), Belgium (ongoing, recruiting), Spain (ongoing, recruiting), Denmark (ongoing, recruiting), Czechia (ongoing, recruiting), Sweden (ongoing, recruiting), France (ongoing, recruiting), Netherlands (ongoing, recruiting), Germany (ongoing, recruiting), Italy (ongoing, recruiting), Finland (ongoing, recruiting), Greece (ongoing, recruiting), Croatia (ongoing, recruiting), Portugal (ongoing, recruiting), Slovenia (authorised, recruiting), Slovakia (ongoing, recruiting).
Therapeutic area(s): Diseases [C] - Hemic and Lymphatic Diseases [C15]
Gender: Female, Male. Age: 18-64 years, 65+ years. Enrolment: 394.
Start date (EU): 2024-05-27. Decision date: 2024-05-06. Results received: No. Last updated: 2026-02-16.
Decision dates by country: ES: 2024-05-09, SK: 2025-05-05, SE: 2024-05-15, NL: 2024-05-06, GR: 2024-05-15, FR: 2024-05-15, SI: 2025-04-17, DK: 2024-05-15, HR: 2025-05-26, FI: 2024-05-15, NO: 2024-05-06, DE: 2024-05-15, CZ: 2024-05-15, BE: 2024-05-13, PT: 2025-03-31, IT: 2024-05-15

Condition(s): Relapsed/Refractory Multiple Myeloma
Product: Bortezomib STADA 2,5 mg/ml Injektionslösung, Dexamethason 0,5 mg JENAPHARM®, Empliciti 400 mg powder for concentrate for solution for infusion., Kyprolis 60 mg powder for solution for infusion, Privigen 100 mg/ml solution for infusion, Privigen 100 mg/ml solution for infusion, Imnovid 1 mg hard capsules, Nodexon 20 mg tabletes, Imnovid 3 mg hard capsules, Imnovid 4 mg hard capsules, Imnovid 2 mg hard capsules, Nodexon 20 mg tabletės, ELRANATAMAB, Dexamethason 4 mg JENAPHARM®

Primary endpoint: PFS (progression free survival) by BICR (blinded independent central review) per IMWG (International Myeloma Working Group)
Endpoint(s): OS (overall survival), • PFS by Investigator per IMWG • PFS2 (PFS on next line therapy) by Investigator per IMWG • ORR (objective response rate) by BICR per IMWG • DOR (duration of response) by BICR per IMWG • VGPRR (very good partial response rate) (≥VGPR) (very good partial response) by BICR per IMWG • CRR (complete response rate) by BICR per IMWG • DOCR (duration of complete response) by BICR per IMWG • TTR (time to response) by BICR per IMWG, • AEs (adverse events) • Laboratory abnormalities, •PFS by BICR per IMWG •OS (overall survival) •PFS and PFS2 by Investigator per IMWG •ORR by BICR per IMWG • DOR by BICR per IMWG • VGPRR by BICR per IMWG •CRR by BICR per IMWG •DOCR by BICR per IMWG •TTR by BICR per IMWG •MRD negativity rate per IMWG •Sustained MRD negativity rate for at least 12 months per IMWG •AEs •Laboratory abnormalities, Pre- and post-dose concentrations of elranatamab, ADA (antidrug antibody) and NAb (neutralizing antibody) against elranatamab, • Change from baseline EORTC QLQ-C30 (European Organisation for Research and Treatment of Cancer Quality of Life Cancer Questionnaire 30) scores (global health, fatigue, pain, physical functioning, role functioning, and emotional functioning domains) • Change from baseline MY20 (multiple myeloma module quality of life questionnaire) scores (disease symptoms, side-effects of treatment, body image, and future perspective domains)

Source: https://euclinicaltrials.eu/ctis-public/view/2023-507871-23-00